EU clinical trial 2022-501342-29-00: A Phase 3, Randomized Study to Evaluate the Efficacy and Safety of Pembrolizumab (MK-3475) + Lenvatinib (E7080/MK-7902) + Chemotherapy Compared with Standard of Care as First-line Intervention in Participants with Metastatic Esophageal Carcinoma
Protocol code: MK 7902-014
Sponsor: Merck Sharp & Dohme LLC (Pharmaceutical company). Phase: Therapeutic confirmatory (Phase III). Countries: Spain (ended), Hungary (ended), France (ended), Denmark (ended), Italy (ended), Romania (ended).
Therapeutic area(s): Diseases [C] - Neoplasms [C04]
Gender: Female, Male. Age: 18-64 years, 65+ years. Enrolment: 136.
Status: Ended. Start date (EU): 2021-07-21. End date (EU): 2026-05-11. End date: 2026-05-20. Decision date: 2023-07-25. Results received: No. Last updated: 2026-06-04.
Decision dates by country: HU: 2023-07-25, RO: 2023-09-13, IT: 2023-09-13, FR: 2023-08-03, ES: 2023-07-31, DK: 2023-08-10

Condition(s): Esophageal Carcinoma
Product: Lenvatinib, Lenvatinib, KEYTRUDA 25 mg/mL concentrate for solution for infusion, CALCIUM FOLINATE, CISPLATIN, FLUOROURACIL, Lenvatinib, OXALIPLATIN, SODIUM LEVOFOLINATE

Primary endpoint: Part 1 (5-Fluorouracil [5-FU] plus cisplatin [FP] and paclitaxel plus cisplatin [TP] Safety Run-in): Number of Participants With Dose Limiting Toxicities (DLTs), Part 1 (FP and TP Safety Run-in): Number of Participants With Adverse Events (AEs), Part 1 (FP and TP Safety Run-in): Number of Participants who Discontinued Study Treatment Due to an AE, Part 2 (Main Study): Overall Survival (OS) in all Participants
Endpoint(s): Part 2 (Main Study): Progression-free Survival (PFS) per Response Evaluation Criteria in Solid Tumors Version 1.1 (RECIST 1.1) as Assessed by Blinded Independent Central Review (BICR) in all Participants, Part 2 (Main Study): Objective Response Rate (ORR) per RECIST 1.1 as Assessed by BICR in all Participants, Part 2 (Main Study): Duration of Response (DOR) per RECIST 1.1 as Assessed by BICR in all Participants, Part 2 (Main Study): OS in Participants With Programmed Cell Death-Ligand 1 (PD-L1) Combined Positive Score (CPS) ≥10, Part 2 (Main Study): PFS per RECIST 1.1 as Assessed by BICR in Participants With PD-L1 CPS ≥10, Part 2 (Main Study): ORR per RECIST 1.1 as Assessed by BICR in Participants With PD-L1 CPS ≥10, Part 2 (Main Study): DOR per RECIST 1.1 as Assessed by BICR in Participants With PD-L1 CPS ≥10, Part 2 (Main Study): Number of Participants With AEs, Part 2 (Main Study): Number of Participants who Discontinued Study Treatment Due to an AE

Source: https://euclinicaltrials.eu/ctis-public/view/2022-501342-29-00